EU clinical trial 2024-515663-59-00: Efficacy of prophylactic levetiracetam for improving functional outcome in the acute phase of intracerebral haemorrhage: a randomised, double-blind, placebo-controlled, phase 3 trial; PEACH 2
Protocol code: 69HCL23_0934
Sponsor: Hospices Civils De Lyon (Hospital/Clinic/Other health care facility). Phase: Therapeutic confirmatory (Phase III). Countries: France (authorised, recruitment pending).
Therapeutic area(s): Diseases [C] - Nervous System Diseases [C10]
Gender: Female, Male. Age: 18-64 years, 65+ years. Enrolment: 580.
Status: Authorised, recruitment pending. Decision date: 2026-04-02. Results received: No. Last updated: 2026-04-02.

Condition(s): intracerebral haemorrhage
Product: Keppra 250 mg film-coated tablets, Keppra 100 mg/ml concentrate for solution for infusion, Lévétiracetam 125mg PLACEBO, lEVETIRACETAM 100MG/ML

Primary endpoint: Functional status (death or dependency) at 6 months will be measured by the modified Rankin Scale (mRS), using ordinal logistic regression, adjusted for the stratification criterion. The mRS score will be measured during a face-to-face or remotely (if needed because of patients’ clinical status) with a standardised guided interview by a certified stroke neurologist or a certified clinical research associate (only remotely) at the 6 month-follow up visit, blinded to the patient study group.
Endpoint(s): number of clinical seizures within 72 h and at 1, 6 and 12 months, change in National Institute of Health Stroke Scale (NIHSS, 11 items version) score between inclusion and 72 h and 6 months., cognitive impairment assessed by the Montreal Cognitive Assessment (MoCA) version 8.3 at 6 months., Cognitive complaint assessed by the Functional Assessment of Cancer Therapy-Cognitive Function (FACT-Cog) version 3 at 6 months., Quality of life assessed by the EuroQol - 5D-5L (EQ-5D-5L) at 6 and 12 months., modified Rankin Scale (mRS) score at 12 months, Change in intracerebral haemorrhage volume (cc) and mass effect (mm) defined as midline shift on control brain imaging at 72 hours, Frequency of side effects related to treatment at 1 and 6 months, Frequency of pneumonia at 1 month, Frequency of delirium at 1 month, - anxiety and depression evaluated with the Hospital Anxiety and Depression Scale (HADS) at one and 6 months., all-cause mortality at 1, 6 and 12 months

Source: https://euclinicaltrials.eu/ctis-public/view/2024-515663-59-00